EU clinical trial 2024-511922-30-00: A Randomized, Parallel Group Study to Evaluate the Safety, Pharmacokinetics, and Dose Response of Paltusotine Treatment in Subjects with Carcinoid Syndrome
Protocol code: CRN00808-11
Sponsor: Crinetics Pharmaceuticals Inc. (Pharmaceutical company). Phase: Therapeutic exploratory (Phase II). Countries: Poland (ended).
Therapeutic area(s): Diseases [C] - Digestive System Diseases [C06]
Gender: Female, Male. Age: 18-64 years, 65+ years. Enrolment: 2.
Status: Ended. Start date (EU): 2023-05-11. End date (EU): 2026-01-16. End date: 2026-02-24. Decision date: 2024-08-06. Results received: No. Last updated: 2026-01-30.

Condition(s): Carcinoid Syndrome
Product: OCTREOTIDE ACETATE, Paltusotine tablets

Primary endpoint: Safety: Incidence of TEAEs, including serious TEAEs and TEAEs leading to discontinuation; change from Baseline to the EOR in safety parameters: clinical laboratory tests, physical exam findings, vital signs, 12-lead ECG, and 24-hour continuous cardiac monitoring (only for subjects on 120 mg dose), Pharmacokinetics: Steady state trough levels at each dose at EOR

Source: https://euclinicaltrials.eu/ctis-public/view/2024-511922-30-00